EU clinical trial 2023-508949-40-00: A multicentre, randomised, double-blind, placebo-controlled, parallel-group phase 2 trial to evaluate the efficacy and safety of BP1.7881 in adult patients with eosinophilic esophagitis.
Protocol code: P22-04 / BP1.7881
Sponsor: Bioprojet Pharma (Pharmaceutical company). Phase: Therapeutic exploratory (Phase II). Countries: Italy (ongoing, recruiting), France (ongoing, recruiting).
Therapeutic area(s): Diseases [C] - Immune System Diseases [C20]
Gender: Female, Male. Age: 18-64 years, 65+ years. Enrolment: 24.
Status: Ongoing, recruiting. Start date (EU): 2024-11-29. Decision date: 2024-06-26. Results received: No. Last updated: 2026-04-10.
Decision dates by country: IT: 2024-06-26, FR: 2024-06-28

Condition(s): Eosinophilic esophagitis
Product: Matching orodispersible placebo tablet

Primary endpoint: Proportion of patients achieving peak esophageal intraepithelial eosinophil count of ≤6 eos/hpf at week 12.
Endpoint(s): Change in total EoE-Dysphagia Assessment Questionnaire (EDAQ) score from baseline to week 12., Change inEosinophilic Esophagitis-Endoscopic Reference Score (EoE-EREFS) from baseline to week 12., Percent change in peak esophageal intraepithelial eosinophil count (eos/hpf)., Change in EoE Grade Score from the Histology Scoring System (EoE-HSS) from baseline to week 12., Change in EoE Stage Score from the EoE-HSS from baseline to week 12.

Source: https://euclinicaltrials.eu/ctis-public/view/2023-508949-40-00